EU clinical trial 2023-505089-27-00: A Phase III, Multicenter, Single-Arm Study Evaluating the Efficacy, Safety, Pharmacokinetics, and Pharmacodynamics of Crovalimab in Adult and Adolescent Patients with atypical Hemolytic Uremic Syndrome (aHUS)
Protocol code: BO42353
Sponsor: F. Hoffmann-La Roche AG (Pharmaceutical company). Phase: Therapeutic confirmatory (Phase III). Countries: Germany (ongoing, recruitment ended), Hungary (ongoing, recruitment ended), Spain (ended), Poland (ongoing, recruitment ended), Italy (ongoing, recruitment ended), France (ongoing, recruitment ended), Belgium (ongoing, recruitment ended).
Therapeutic area(s): Diseases [C] - Hemic and Lymphatic Diseases [C15]
Gender: Female, Male. Age: 0-17 years, 18-64 years, 65+ years. Enrolment: 19.
Start date (EU): 2021-07-01. Decision date: 2024-02-29. Results received: No. Last updated: 2026-01-26.
Decision dates by country: IT: 2024-03-05, DE: 2024-02-29, HU: 2024-02-29, ES: 2024-03-05, FR: 2024-03-04, BE: 2024-03-08, PL: 2024-04-02

Condition(s): Atypical Hemolytic Uremic Syndrome (aHUS)
Product: Crovalimab

Primary endpoint: 1. Proportion of patients with complete TMA response (cTMAr)
Endpoint(s): 1. Dialysis requirement status (yes/no) change, 2. Observed value and change from baseline in estimated glomerular filtration rate (eGFR), 3. Proportion of patients with change from baseline in chronic kidney disease stage, 4. Observed value and change from baseline in hematologic parameters, 5. In adults (≥ 18 years), change from baseline in fatigue as measured by the Functional Assessment of Chronic Illness Therapy-Fatigue Questionnaire, 6. Incidence and severity of adverse events, 7. Change in targeted vital signs and clinical laboratory test results, 8. Incidence and severity of injection-site reactions, infusion-related reactions, hypersensitivity, malignant hypertension, and infections, 9. Incidence of adverse events leading to study drug discontinuation, 10. Serum concentrations of crovalimab, 11. Prevalence and incidence of anti-drug antibodies (ADAs) to crovalimab, 12. Proportion of patients with platelet count ≥ LLN, 13. Proportion of patients with normalization of LDH, 14. Proportion of patients with ≥ 25% decrease in serum creatinine from baseline, 15. Time to cTMAr, 16. Duration of cTMAr, 17. Proportion of patients with cTMAr, 18. Proportion of patients with maintained TMA control (mTMAc)

Source: https://euclinicaltrials.eu/ctis-public/view/2023-505089-27-00